EU clinical trial 2022-503009-39-00: Multiple Ascending Doses of BMS-986326 in Participants with Discoid Lupus Erythematosus, Subacute Cutaneous Lupus Erythematosus, or Systemic Lupus Erythematosus
Protocol code: IM034-1000
Sponsor: Bristol-Myers Squibb Services Unlimited Company (Pharmaceutical company). Phase: Human Pharmacology (Phase I)- Other. Countries: Netherlands (ended), Poland (ended), Romania (ended), Germany (ended), Spain (ended), Bulgaria (ended).
Therapeutic area(s): Diseases [C] - Immune System Diseases [C20]
Gender: Female, Male. Age: 18-64 years, 65+ years. Enrolment: 37.
Status: Ended. Start date (EU): 2024-06-04. End date (EU): 2025-08-19. End date: 2026-04-15. Decision date: 2023-11-20. Results received: No. Last updated: 2026-04-28.
Decision dates by country: ES: 2023-11-22, NL: 2023-11-20, BG: 2023-12-01, DE: 2023-11-22, PL: 2023-11-27, RO: 2023-12-04

Condition(s): Subacute Cutaneous Lupus Erythematosus, Discoid Lupus Erythematosus, Systemic Lupus Erythematosus

Source: https://euclinicaltrials.eu/ctis-public/view/2022-503009-39-00